EU clinical trial 2025-524953-15-00: Neoadjuvant nivolumab and ipilimumab for patients with high-risk uveal melanoma
Protocol code: MM2530
Sponsor: Region Hovedstaden (Hospital/Clinic/Other health care facility). Phase: Human Pharmacology (Phase I)- Other. Countries: Denmark (authorised, recruiting).
Therapeutic area(s): Diseases [C] - Eye Diseases [C11]; Diseases [C] - Neoplasms [C04]
Gender: Female, Male. Age: 18-64 years, 65+ years. Enrolment: 15.
Status: Authorised, recruiting. Start date (EU): 2026-06-29. Decision date: 2026-02-04. Results received: No. Last updated: 2026-02-04.

Condition(s): Uveal melanoma

Source: https://euclinicaltrials.eu/ctis-public/view/2025-524953-15-00